EU clinical trial 2024-518077-34-00: ACO/ARO/AIO-18.2 Preoperative FOLFOX versus postoperative risk-adapted chemotherapy in patients with locally advanced rectal cancer and low risk for local failure: A randomized phase III trial of the German Rectal Cancer Study Group
Sponsor: Heidelberg University (Educational Institution). Phase: Therapeutic confirmatory (Phase III). Countries: Germany (ongoing, recruitment ended).
Therapeutic area(s): Diseases [C] - Neoplasms [C04]
Gender: Female, Male. Age: 18-64 years, 65+ years. Enrolment: 550.
Status: Ongoing, recruitment ended. Start date (EU): 2020-09-30. Decision date: 2024-11-05. Results received: No. Last updated: 2026-05-06.

Condition(s): locally advanced rectal cancer
Product: CAPECITABINE, OXALIPLATIN, CALCIUM FOLINATE PENTAHYDRATE, CAPECITABINE, FLUOROURACIL

Primary endpoint: The primary endpoint of this trial is disease-free survival, defined as the time from randomisation to one of the following events: no surgery or non-radical (R2) surgery of the primary tumour, locoregional recurrence after R0/1 resection of the primary tumour, second primary colorectal or other cancer, metastatic disease or progression, or death from any cause, whichever occurred first.
Endpoint(s): Acute and late toxicity assessment according to NCI CTCAE version 5.0, Compliance (completion rate) of chemotherapy, Surgical morbidity and complications, Pathological UICC-staging, including pCR (ypT0N0) rate, R0 resection rate; negative circumferential resection rate (CRM > 1mm), Tumor regression grading according to Dworak in the experimental arm, Rate of sphincter-sparing surgery, Rate of W&W with or without local regrowth, Cumulative incidence of local and distant recurrences, Overall survival, Quality of life and functional outcome based on treatment arm, and surgical procedures

Source: https://euclinicaltrials.eu/ctis-public/view/2024-518077-34-00